EU clinical trial 2024-516194-76-00: The Efficacy of Pressurised Intraperitoneal aerosol chemotherapy (PIPAC) combined with CURativE intent minimally invasive radical resection in high-risk gastric cancer patients. A multicentre, randomised, open-label phase-II study (EPICURE, PIPAC-OPC6)
Sponsor: Odense University Hospital (Hospital/Clinic/Other health care facility). Phase: Therapeutic exploratory (Phase II). Countries: Sweden (authorised, recruitment pending), Denmark (ongoing, recruiting), France (ongoing, recruiting).
Therapeutic area(s): Diseases [C] - Neoplasms [C04]; Diseases [C] - Digestive System Diseases [C06]
Gender: Female, Male. Age: 18-64 years, 65+ years. Enrolment: 123.
Start date (EU): 2026-05-28. Decision date: 2025-06-23. Results received: No. Last updated: 2025-06-23.
Decision dates by country: DK: 2025-06-23, FR: 2025-06-23, SE: 2025-06-23

Condition(s): Gastric adenocarcinoma
Product: DOXORUBICIN, CISPLATIN

Primary endpoint: Peritoneal disease-free survival (P-DFS) defined as no signs of peritoneal recurrence on PET-CT/CT and diagnostic laparoscopy with at least 12 months follow-up after minimally invasive D2-gastrectomy
Endpoint(s): Disease-free survival (DFS) with at least 12 months of follow-up (through electronic patient records up to five years after surgery), Overall survival with at least 12 months of follow-up (through electronic patient records up to five years after surgery), Length of stay (LOS) (Surgery = Day 0), 30 days postoperative toxicity (CTCAE), 30 days postoperative complications (Dindo-Clavien), 90 days mortality, Rate of positive peritoneal lavage, Quality of life (EORTC QLQ-C30 + QLC-STO22), The rate of included patients not receiving adjuvant chemotherapy as planned due to PIPAC-related complications

Source: https://euclinicaltrials.eu/ctis-public/view/2024-516194-76-00